EU clinical trial 2024-520435-33-00: Safety of oral micronized progesterone versus norethisterone acetate in continuous combination with oral estrogen as menopausal hormone therapy – a double-blind randomized study- PROBES study (Progesterone Breast Endometrial Safety study)
Protocol code: PROBES
Sponsor: Karolinska University Hospital (Hospital/Clinic/Other health care facility). Phase: Therapeutic confirmatory (Phase III). Countries: Sweden (authorised, recruitment pending).
Therapeutic area(s): Diseases [C] - Female Urogenital Diseases and Pregnancy Complications [C13]
Gender: Female. Age: 18-64 years. Enrolment: 520.
Status: Authorised, recruitment pending. Decision date: 2025-01-17. Results received: No. Last updated: 2025-01-17.

Condition(s): Climacteric symptoms
Product: Utrogestan 200 mg mjuk vaginalkapsel, Estrofem 1 mg filmovertrukne tabletter, Pharmaceutical form: Capsule Route of administration: Oral use; Which IMS is it a placebo for?: Utrogestan Is it otherwise identival tio the IMP?: Yes, Activelle 1 mg/0,5 mg filmdragerade tabletter

Primary endpoint: Percentage change in mammographic density compared between the groups.
Endpoint(s): Incidence of endometrial proliferation (proliferation marker (Ki67), Endometrial thickness on ultrasound, Bleeding pattern as documented in a bleeding diary, Gene and protein expression of growth factors and apoptosis markers in breast and endometrial tissue, Depression and anxiety symptoms (Patient Health Questionnaire (PHQ-9), Hospital Anxiety and Depression Scale (HADS)), Health-related quality of life (Psychological General Well-Being Index (PGWB)), Women’s Health Questionnaire (WHQ), Blood lipid profile, serum hormones, growth and metabolic factors (follicle-stimulating hormone, luteinizing hormone, estradiol, progesterone, testosterone, sex hormone-binding globulin, IGF–I and its binding proteins), and coagulation factors (antitrombin, factor V Leiden, factor II mutation, cardiolipin-ab, Lupus anticoagulant, Protein C activity, Protein S free, APT-time, fibrinogen, prothrombin complex, thrombocytes).

Source: https://euclinicaltrials.eu/ctis-public/view/2024-520435-33-00